EU clinical trial 2023-504583-42-00: J1I-MC-GZBU - A Phase 2b, Double-Blind Study to Investigate the Effect of LY3437943 on Renal Function in Participants With Overweight or Obesity and Chronic Kidney Disease With or Without Type 2 Diabetes
Protocol code: J1I-MC-GZBU
Sponsor: Eli Lilly & Co. (Pharmaceutical company). Phase: Therapeutic exploratory (Phase II). Countries: Spain (ended), Italy (ended).
Therapeutic area(s): Diseases [C] - Nutritional and Metabolic Diseases [C18]
Gender: Female, Male. Age: 18-64 years, 65+ years. Enrolment: 18.
Status: Ended. Start date (EU): 2024-05-07. End date (EU): 2025-10-21. End date: 2025-10-22. Decision date: 2023-11-14. Results received: No. Last updated: 2026-06-24.
Decision dates by country: ES: 2023-11-14, IT: 2023-11-14

Condition(s): Overweight or Obesity and Chronic Kidney Disease With or Without Type 2 Diabetes
Product: Placebo to match LY3437943, IOHEXOL, Retatrutide

Primary endpoint: Change in GFR (mL/min/m2 ) using iohexol clearance

Source: https://euclinicaltrials.eu/ctis-public/view/2023-504583-42-00